EU clinical trial 2025-524313-86-00: A single center study to evaluate the safety and tolerability of oral Azathioprine in patients with ADPKD
Sponsor: UZ Leuven (Hospital/Clinic/Other health care facility). Phase: Therapeutic exploratory (Phase II). Countries: Belgium (not authorised).
Therapeutic area(s): Not possible to specify
Gender: Female, Male. Age: 18-64 years, 65+ years. Enrolment: 40.
Status: Not authorised. Decision date: 2026-04-21. Results received: No. Last updated: 2026-04-21.

Condition(s): Autosomal dominant polycystic kidney and liver disease
Product: Azathioprine 50 mg film-coated tablets, Azathioprine 25 mg film-coated tablets

Primary endpoint: % of treatment stop due to leucopenia, % of treatment stop due to liver function distrubances, % of treatment stop due to subjective intolerance of treatment, Number of infections, Patient-reported outcome measures (PROs): Validated questionnaires to assess quality of life (QoL) and symptom burden (e.g. abdominal discomfort, fatigue, physical limitation) will be completed at baseline, week 8, week 32, week 56 and week 60.
Endpoint(s): Log-transformed annualised relative change of height adjusted total kidney volume (htTKV) and ht total liver volume (htTLV) (%/year) from baseline to week 56 of treatment, Change in eGFR from baseline eGFR to week 52 of treatment

Source: https://euclinicaltrials.eu/ctis-public/view/2025-524313-86-00